EU clinical trial 2022-501184-41-00: A phase IV randomised, double-blind, parallel-design, controlled multi-center trial of a NOVel moisturiser for Atopic dermatitis: effect on relapse prevention in children, NOVA II
Sponsor: Aco Hud Nordic AB (Pharmaceutical company). Phase: Therapeutic use (Phase IV). Countries: Germany (ended), Sweden (ended).
Therapeutic area(s): Diseases [C] - Skin and Connective Tissue Diseases [C17]
Gender: Female, Male. Age: 0-17 years. Enrolment: 270.
Status: Ended. Start date (EU): 2023-02-13. End date (EU): 2024-05-02. Decision date: 2022-12-06. Results received: No. Last updated: 2023-10-23.
Decision dates by country: SE: 2023-10-23, DE: 2022-12-06

Condition(s): atopic dermatitis/eczema
Product: Essex, creme, Advantan® 0,1% Creme, Linola Fett, ECURAL ® Fettcreme, 1 mg/g Creme, Miniderm Duo 20 mg/g + 200 mg/g kräm

Primary endpoint: Relapse of atopic eczema, measured as a hazard ratio. Definition of relapse is an episode that, from the participants/participants’ parent(s) and/or legal guardian(s)’s perspective, requires escalation of treatment of the study area eczemas. Date of relapse will be noted in the eDiary and confirmed by the Investigator.
Endpoint(s): Time to relapse of atopic eczema (days), Proportion of participants still eczema free after 1, 2, 3, 4, 5 and 6 months maintenance treatment, Absolute and relative risk reduction, Assessment of disease severity using PO-SCORAD, and POEM (visits 1-4), Assessment of peak itch intensity by VAS obtained from PO-SCORAD (Visits 1-4), Weekly assessment of disease severity by using RECAP during the maintenance phase, Quality of life, assessed by disease specific instruments using IDQoL (below four years) or CDLQI (above four years) (Visits 1-4), Quality of life, assessed by general instrument EQ-5D-Y (participants above four years) (Visits 1-4), Cream consumption, based on weight of IP product before and after use (Visit 2 and Visit 4), Questionnaire for evaluation of cosmetic/organoleptic properties of the creams by participant or parents/guardians, Questionnaire connected to microbiome for those consenting for microbiome swabbing, Number of participants with FLG loss-of-function mutations and evidence of a relationship to treatment effects, Tolerability, measured as smarting/stinging on a VAS immediately and 5 minutes after first application (V2) and after one week of treatment, Number of participants with Treatment-Emergent Adverse Events (AEs) [Time Frame: Baseline (Day 1) up to Day 180/relapse]

Source: https://euclinicaltrials.eu/ctis-public/view/2022-501184-41-00